EU clinical trial 2024-517081-42-00: A Multicenter, Randomized, Double-blind, Placebo-controlled, Phase 2a Trial to Characterize the Efficacy and Safety of TEV-53408 in Adults with Celiac Disease While Undergoing Oral Gluten Exposure
Protocol code: TV53408-IMM-20042
Sponsor: Teva Branded Pharmaceutical Products R&D LLC (Pharmaceutical company). Phase: Therapeutic exploratory (Phase II). Countries: Finland (ongoing, recruitment ended).
Therapeutic area(s): Diseases [C] - Digestive System Diseases [C06]
Gender: Female, Male. Age: 18-64 years, 65+ years. Enrolment: 5.
Status: Ongoing, recruitment ended. Start date (EU): 2025-08-15. Decision date: 2025-04-07. Results received: No. Last updated: 2026-06-26.

Condition(s): Celiac Disease
Product: TEV-53408, Placebo to match TEV-53408

Primary endpoint: Change from baseline in villous atrophy, as assessed by Vh:Cd, at week 8., Incidence of treatment-emergent adverse events up to week 28., Incidence of serious adverse events up to week 28., Incidence of PDAESIs up to week 28., Incidence of early discontinuations during the treatment period (up to week 28) due to an adverse event.
Endpoint(s): Change from baseline in IEL density at week 8., Change from baseline in a composite measure of VCIEL at week 8.

Source: https://euclinicaltrials.eu/ctis-public/view/2024-517081-42-00